EU clinical trial 2023-504187-42-00: A Phase 1, First-in-human Study of JNJ-80948543, a T-cell Redirecting Antibody, in Participants with NHL and CLL
Protocol code: 80948543LYM1001
Sponsor: Janssen - Cilag International (Pharmaceutical company). Phase: Human Pharmacology (Phase I)- First administration to humans. Countries: Denmark (ongoing, recruitment ended), France (ongoing, recruitment ended), Poland (ended).
Therapeutic area(s): Diseases [C] - Neoplasms [C04]
Gender: Female, Male. Age: 18-64 years, 65+ years. Enrolment: 65.
Start date (EU): 2022-09-12. Decision date: 2023-07-12. Results received: No. Last updated: 2025-11-15.
Decision dates by country: PL: 2023-08-22, FR: 2023-07-25, DK: 2023-07-12

Condition(s): Non-Hodgkin Lymphoma (NHL) and Chronic Lymphocytic Leukemia (CLL)

Source: https://euclinicaltrials.eu/ctis-public/view/2023-504187-42-00